EU clinical trial 2024-512619-28-00: A Seamless, Adaptive, Phase 2b/3, Double-Blind, Randomized, Placebo-controlled, Multicenter, International Study Evaluating the Efficacy and Safety of Belapectin (GR MD-02) for the Prevention of Esophageal Varices in NASH Cirrhosis.
Protocol code: GT-031
Sponsor: Galectin Therapeutics Inc. (Pharmaceutical company). Phase: Phase II and Phase III (Integrated). Countries: Belgium (ended), Spain (ended), France (ended), Germany (ended), Poland (ended).
Therapeutic area(s): Diseases [C] - Nutritional and Metabolic Diseases [C18]
Gender: Female, Male. Age: 18-64 years, 65+ years. Enrolment: 28.
Status: Ended. Start date (EU): 2021-03-08. End date (EU): 2025-02-18. End date: 2025-03-11. Decision date: 2024-05-21. Results received: Yes. Last updated: 2025-01-30.
Decision dates by country: BE: 2024-05-22, FR: 2024-05-22, DE: 2024-05-22, PL: 2024-05-21, ES: 2024-05-22

Condition(s): Esophageal Varices in NASH Cirrhosis
Product: Placebo of BELAPECTIN, BELAPECTIN

Primary endpoint: Proportion of patients in the belapectin treatment groups who develop esophageal varices at 78 weeks (18 months) of treatment compared to placebo.
Endpoint(s): Incidence rate of patients in the belapectin treatment groups, compared to placebo, who develop any of:1)varices (esophageal or gastric) requiring treatment,2)variceal bleed requiring hospitalization,3)clinically significant ascites requiring hospitalization,4)spontaneous bacterial peritonitis,5)overt hepatic encephalopathy (West Haven score ≥2 and requiring hospitalization),6)mortality(all-cause),7)liver transplant,8)model for end-stage liver disease(MELD)score ≥15 on 2 consecutive occasions.

Source: https://euclinicaltrials.eu/ctis-public/view/2024-512619-28-00